EU clinical trial 2024-516189-12-00: Role of Hydroxychloroquine in therapeutic strategy of Head and Neck cancer and Non-small cell lung cancer
Protocol code: HCQHNLcancer
Sponsor: Ospedale San Raffaele S.r.l. (Hospital/Clinic/Other health care facility). Phase: Therapeutic exploratory (Phase II). Countries: Italy (ended).
Therapeutic area(s): Diseases [C] - Neoplasms [C04]
Gender: Female, Male. Age: 18-64 years, 65+ years. Enrolment: 20.
Status: Ended. End date (EU): 2025-07-18. Decision date: 2024-07-29. Results received: No. Last updated: 2024-07-29.

Condition(s): Patients affected by Resectable Head and Neck (HN) cancer (only Squamous Cell Carcinoma of the oral cavity or larynx), or Resectable Non-small cell lung cancer (NSCLC, only Lung Squamous Cell Carcinoma or Adenocarcinoma).
Product: HYDROXYCHLOROQUINE

Primary endpoint: The biological effect of HCQ will be evaluated using immunohistochemical studies performed for known autophagic and immunological markers (CD3, CD8, CD163, p53, p62, LC3) with quantification of positivity / total cells, intensity, expression pattern. Eventual tumor cytoarchitectural modification and tumor lymphocyte infiltrate will be evaluated and scored using standard grading system.

Source: https://euclinicaltrials.eu/ctis-public/view/2024-516189-12-00